EU clinical trial 2024-519673-18-00: A randomized phase 2 trial of neoadjuvant pembrolizumab plus belzutifan with or without lenvatinib in patients with localized renal cell carcinoma. The moonlanding trial
Protocol code: VHIO24002
Sponsor: Vall D Hebron Institute Of Oncology (Laboratory/Research/Testing facility). Phase: Therapeutic exploratory (Phase II). Countries: Spain (authorised, recruitment pending).
Therapeutic area(s): Diseases [C] - Neoplasms [C04]
Gender: Female, Male. Age: 18-64 years, 65+ years. Enrolment: 90.
Status: Authorised, recruitment pending. Decision date: 2026-04-24. Results received: No. Last updated: 2026-04-24.

Condition(s): Patients with localized renal cell carcinoma
Product: Lenvatinib, Belzutifan, Lenvatinib, KEYTRUDA 25 mg/mL concentrate for solution for infusion

Primary endpoint: Radiographic response defined as a decrease of initial tumour size ≥30% from baseline to the week 12 CT scan, as assessed by the investigator per RECIST v1.1 criteria.
Endpoint(s): Adverse event (AE) rate, study intervention discontinuation due to AEs, rates of surgery delayed >4 weeks due to AEs from neoadjuvant treatment., 30-day mortality and Clavien-Dindo classification., Patient reported outcomes (PRO) scores for the following domains: EORTC QLQ-C30 global health status/HRQoL (Items 29-30); EORTC QLQ-C30 physical functioning (Items 1-5); EORTC QLQ-C30 role functioning (Items 6-7); FKSI-DRS Subscale (Items 1-9)

Source: https://euclinicaltrials.eu/ctis-public/view/2024-519673-18-00